EU clinical trial 2023-506814-31-01: Pragmatic clinical trial to assess the utility of SLCO1B1, ABCG2, and CYP2C9 preepmtive genotyping and pharmacogenetics training on the incidence of musculoskeletal adverse reactions in patients treated with statins in primary and specialized care.
Protocol code: Ap-PriME
Sponsor: Fundacion Para La Investigacion Biomedica Del Hospital Universitario La Princesa (Laboratory/Research/Testing facility). Phase: Therapeutic use (Phase IV). Countries: Spain (ongoing, recruiting).
Therapeutic area(s): Phenomena and Processes [G] - Musculoskeletal and Neural Physiological Phenomena [G11]; Diseases [C] - Cardiovascular Diseases [C14]; Phenomena and Processes [G] - Genetic Phenomena [G05]
Gender: Female, Male. Age: 18-64 years, 65+ years. Enrolment: 1000.
Status: Ongoing, recruiting. Start date (EU): 2024-06-25. Decision date: 2024-02-19. Results received: No. Last updated: 2024-02-19.

Condition(s): Cardiovascular risk which needs primary or secundary prevention with statins
Product: PRAVASTATIN, ATORVASTATIN, PITAVASTATIN, FLUVASTATIN, ROSUVASTATIN

Primary endpoint: The incidence of musculoskeletal adverse reactions induced during the first 6 months of treatment (measurement at 6 months).
Endpoint(s): The incidence of musculoskeletal adverse reactions at 12 months or longer follow up.

Source: https://euclinicaltrials.eu/ctis-public/view/2023-506814-31-01